EU clinical trial 2023-504461-23-00: An Open-Label, Fixed-Sequence, Drug-Drug Interaction Study in Healthy Participants to Evaluate the Effect of AGMB-129 on the Pharmacokinetics of Midazolam, a Sensitive Index Substrate of CYP3A4
Sponsor: Agomab Spain S.L. (Pharmaceutical company). Phase: Human Pharmacology (Phase I)- Other. Countries: Belgium (ended).
Therapeutic area(s): Diseases [C] - Digestive System Diseases [C06]
Gender: Female, Male. Age: 18-64 years. Enrolment: 14.
Status: Ended. Start date (EU): 2023-06-26. End date (EU): 2023-08-29. Decision date: 2023-06-26. Results received: Yes. Last updated: 2023-08-09.

Condition(s): Fibrostenotic Crohn’s disease
Product: BUCCOLAM 2.5 mg oromucosal solution, BUCCOLAM 2.5 mg oromucosal solution, BUCCOLAM 2.5 mg oromucosal solution, BUCCOLAM 2.5 mg oromucosal solution

Primary endpoint: Pharmacokinetic parameters of Midazolam (and its metabolite 1-OH-midazolam) in plasma: Cmax and AUC0-∞.
Endpoint(s): Pharmacokinetic parameters of AGMB-129 and its metabolites MET-158 and MET-154 in plasma, Evaluation throughout the study of: - Frequency and severity of TEAEs and SAEs, and TEAEs leading to IP discontinuation. - Clinical laboratory tests. - Vital signs. - Physical examination.

Source: https://euclinicaltrials.eu/ctis-public/view/2023-504461-23-00